EU clinical trial 2023-509105-72-00: C4601003 - A PHASE 3, MULTICENTER, PLACEBO-CONTROLLED, RANDOMIZED, OBSERVER-BLINDED TRIAL TO EVALUATE THE EFFICACY, SAFETY, TOLERABILITY, IMMUNOGENICITY, AND LOT CONSISTENCY OF A 6-VALENT OSPA-BASED LYME DISEASE VACCINE IN HEALTHY PARTICIPANTS ≥5 YEARS OF AGE
Protocol code: C4601003
Sponsor: Pfizer Inc. (Pharmaceutical company). Phase: Therapeutic confirmatory (Phase III). Countries: Sweden (ended), Netherlands (ended), Poland (ended), Finland (ended), Germany (ended).
Therapeutic area(s): Diseases [C] - Bacterial Infections and Mycoses [C01]
Gender: Female, Male. Age: 0-17 years, 18-64 years, 65+ years. Enrolment: 3000.
Status: Ended. Start date (EU): 2022-08-10. End date (EU): 2025-12-23. End date: 2026-01-07. Decision date: 2024-10-01. Results received: Yes. Last updated: 2026-03-04.
Decision dates by country: PL: 2024-11-11, NL: 2024-10-02, FI: 2024-10-07, SE: 2024-10-01, DE: 2024-10-07

Condition(s): Active immunization against Lyme disease
Product: VLA15, SODIUM CHLORIDE SOLUTION 0.9%

Primary endpoint: Primary Efficacy: • Clinically and laboratory confirmed Lyme disease caused by B burgdorferi sensu lato (as determined by the AC). Primary Safety • Local reactions (pain at the injection site, redness, and swelling). • Systemic events (fever, headache, fatigue, muscle pain, and joint pain). • AEs. • NDCMCs. • SAEs. Primary Immunogenicity • Anti-OspA quantitative immunological assay titer.
Endpoint(s): Secondary Efficacy 1. Clinically and laboratory confirmed Lyme disease caused by B burgdorferi sensu lato (as determined by the AC)., Secondary Efficacy 2. Clinically and laboratory confirmed Lyme disease caused by B burgdorferi sensu lato (as determined by the AC).

Source: https://euclinicaltrials.eu/ctis-public/view/2023-509105-72-00